EU clinical trial 2024-511937-37-01: A single arm single center exploratory observational phase II study, aimed to detect long term changes in volume of port-wine macrocheilia and color of port-wine stain in patients undergoing surgery and laser therapy during sirolimus treatment. Quality of life and efficacy and safety of sirolimus will be assessed.
Protocol code: PLASS-Q
Sponsor: Oslo University Hospital HF (Hospital/Clinic/Other health care facility). Phase: Therapeutic exploratory (Phase II). Countries: Norway (authorised, recruitment pending).
Therapeutic area(s): Diseases [C] - Hemic and Lymphatic Diseases [C15]
Gender: Female, Male. Age: 0-17 years, 18-64 years. Enrolment: 20.
Status: Authorised, recruitment pending. Decision date: 2026-06-15. Results received: No. Last updated: 2026-06-15.

Condition(s): Vascular malfomation
Product: Rapamune 1 mg/mL oral solution, Rapamune 2 mg coated tablets

Primary endpoint: • The primary endpoint is relative change in volume of PWM from baseline to 60 months. Volume will be evaluated in 3 dimensions with at caliper.
Endpoint(s): • The main secondary endpoint is change in color intensity of PWS from baseline to 60 months. Color will be evaluated four categories light red/pink, deep red, bluish red and purple., • The additional secondary endpoint is change of quality of life from baseline to 60 months. Quality of life will be evaluated by OVAMA face and neck score.

Source: https://euclinicaltrials.eu/ctis-public/view/2024-511937-37-01